EU clinical trial 2024-519974-38-00: Randomized controlled trial comparing conventional antibiotic strategies versus regimens guided by epidemiological surveillance in infected patients with cirrhosis.
Protocol code: SURVIC_STUDY
Sponsor: Fundacio De Recerca Clinic Barcelona-Institut D’Investigacions Biomediques August Pi I Sunyer (Laboratory/Research/Testing facility). Phase: Therapeutic use (Phase IV). Countries: Spain (ongoing, recruiting).
Therapeutic area(s): Diseases [C] - Digestive System Diseases [C06]
Gender: Female, Male. Age: 18-64 years, 65+ years. Enrolment: 198.
Status: Ongoing, recruiting. Start date (EU): 2024-12-22. Decision date: 2024-12-19. Results received: No. Last updated: 2024-12-19.

Condition(s): Hospitalized patients with decompensated cirrhosis, diagnosed with bacterial infection evolution lasting for 48 hours or less.
Product: Norfloxacino Sandoz 400 mg comprimidos EFG

Primary endpoint: Probability/rate of participants of developing antibiotic resistance in both treatment arms at 28 days (composite variable: MDRO colonization and/or infection).
Endpoint(s): Evaluate the impact of both antibiotic strategies on: - Rate and probability of developing antibiotic resistance during hospitalization. - Rate and probability of MDRO colonization during hospitalization and at 28 days. - Rate and probability of MDRO infection during hospitalization and at 28 days. - Infection resolution rate with initial and final strategies. - Evolution of scores: ACLF, MELD, Child-Pugh, CLIF-OF, CLIF- C AD, and CLIF-C ACLF score., Days of admission to the ICU if needed., Days of life support (dialysis, vasopressors, and mechanical ventila- tion) if needed., Days of hospital stay., Number of rehospitalizations., Antibiotics consumption (days, dose and type of antibiotics) and health costs (cost of antibiotic, cost of hospital/ICU stay and of organ support(s))., Proportion of participants with antibiotic-related AE, SAEs, SUSARs and other SAEs., Hospital and 28-day survival.

Source: https://euclinicaltrials.eu/ctis-public/view/2024-519974-38-00